EU clinical trial 2024-518570-13-00: Perioperative systemic therapy and cytoreductive surgery with HIPEC versus upfront cytoreductive surgery with HIPEC alone for resectable colorectal peritoneal metastases: a multicentre, open-label, parallel-group, phase II-III, randomised, superiority study (CAIRO6).
Sponsor: Catharina Ziekenhuis Stichting (Hospital/Clinic/Other health care facility). Phase: Phase II and Phase III (Integrated). Countries: Belgium (authorised, recruitment pending), Netherlands (authorised, recruitment pending).
Therapeutic area(s): Diseases [C] - Neoplasms [C04]
Gender: Female, Male. Age: 18-64 years, 65+ years. Enrolment: 358.
Status: Authorised, recruitment pending. Decision date: 2024-11-12. Results received: No. Last updated: 2024-11-13.
Decision dates by country: BE: 2024-11-13, NL: 2024-11-12

Condition(s): Resectable peritoneal metastases of a colorectal origin
Product: Avastin 25 mg/ml concentrate for solution for infusion., Leucovorin-Teva 10 mg/ml Concentrate for Solution for Infusion, Oxaliplatin Eugia 5 mg/ml concentraat voor oplossing voor infusie, Xeloda 150 mg film-coated tablets, 5-Fluorouracil Sandoz 50 mg/ml koncentrátum oldatos infúzióhoz, IRINOTECAN MYLAN GENERICS 20 mg/ml concentrato per soluzione per infusione

Primary endpoint: To determine the difference between both treatments in terms of overall survival (calculated from the interval from diagnosis of peritoneal metastases until death or last follow-up).

Source: https://euclinicaltrials.eu/ctis-public/view/2024-518570-13-00